EU clinical trial 2023-506721-11-00: Randomized controlled trial in patients on long-term colchicine with colchicine-resistant familial Mediterranean fever (FMF) to evaluate the efficacy of on-demand Anakinra treatment for painful attacks in patients who refuse continuous daily therapy (KIN-ATTACK-FMF).
Sponsor: Assistance Publique Hopitaux De Paris (Hospital/Clinic/Other health care facility). Phase: Therapeutic confirmatory (Phase III). Countries: France (ongoing, recruiting).
Therapeutic area(s): Diseases [C] - Immune System Diseases [C20]
Gender: Female, Male. Age: 0-17 years, 18-64 years, 65+ years. Enrolment: 50.
Status: Ongoing, recruiting. Start date (EU): 2024-06-04. Decision date: 2024-02-26. Results received: No. Last updated: 2026-06-03.

Condition(s): Familial Mediterranean Fever (FMF)
Product: Kineret 100 mg/0.67 ml solution for injection in pre-filled syringe., COLCHICINE OPOCALCIUM 1 mg, comprimé sécable

Primary endpoint: Mean number of painful days per month at 6 months of treatment.
Endpoint(s): Efficacy: −Cumulative days of FMF attack treatment from randomization to 6 months, - AIDAI (Auto-inflammatory Diseases activity index) score D0 and M6 Number of painful days and severity of FMF attacks (measured by VAS Visual Analogue Scale) occurring between randomization and M6 − Quality of life score measured by EuroQOL questionnaire (EQ-5D5L) at M6, Safety: − Number of local cutaneous reaction at 6 months (erythema and oedema involving the injection sites) in the anakinra arm − Proportion of adverse events

Source: https://euclinicaltrials.eu/ctis-public/view/2023-506721-11-00